EU clinical trial 2023-504838-21-00: A Randomised Double-Blinded, Placebo-Controlled, Single and Multiple Ascending Dose, Phase 1 Study to Evaluate the Safety, Tolerability, and Pharmacokinetics of LY3876602 in Healthy Participants.
Protocol code: J4K-MC-LALA
Sponsor: Eli Lilly & Co. (Pharmaceutical company). Phase: Human Pharmacology (Phase I)- First administration to humans. Countries: Netherlands (ended).
Therapeutic area(s): Diseases [C] - Nervous System Diseases [C10]
Gender: Female, Male. Age: 18-64 years. Enrolment: 69.
Status: Ended. Start date (EU): 2025-01-08. End date (EU): 2025-09-20. Decision date: 2023-08-08. Results received: No. Last updated: 2025-06-13.

Condition(s): Healthy

Source: https://euclinicaltrials.eu/ctis-public/view/2023-504838-21-00